EU clinical trial 2022-501562-22-01: "CUPCAKE": Early detection of triple negative breast cancer relapse: a clinical utility trial
Protocol code: IC 2022-02
Sponsor: Institut Curie (Laboratory/Research/Testing facility, Hospital/Clinic/Other health care facility). Phase: Therapeutic exploratory (Phase II). Countries: France (ongoing, recruiting).
Therapeutic area(s): Diseases [C] - Neoplasms [C04]; Analytical, Diagnostic and Therapeutic Techniques and Equipment [E] - Diagnosis [E01]
Gender: Female. Age: 18-64 years, 65+ years. Enrolment: 450.
Status: Ongoing, recruiting. Start date (EU): 2026-01-05. Decision date: 2023-12-11. Results received: No. Last updated: 2026-07-03.

Condition(s): Triple-negative breast cancer (TNBC) patients at high risk of relapse
Product: 68Ga-FAPI-46

Primary endpoint: Overall survival rate 36 months after the randomization. The population of interest consists in randomized patients. A non-comparative analysis will be conducted in the experimental arm, and the control arm will serve as reference
Endpoint(s): 1. Number of metastatic sites at the time of the clinical/radiological relapse; 2. Proportion of patients receiving local treatment for oligometastatic disease. 3. RFS [recurrence-free survival]; PFS [progression-free survival]; 1L-PFS [first line PFS]; 2L-PFS [second line PFS]. 4. Best ORR [overall response rate].5. OS not limited to the first 36 months, Proportion of patients presenting with an altered general condition (PS ≥2) at first evidence of clinical or radiological relapse. The population of interest consists in randomized patients., AEs and SAEs, considered by the investigator as related to either ctDNA analysis or 68Ga-FAPI-46 PET-CT, reported by rate and grade (NCI CTC-AEs v5.0). The population of interest consists in all included patients, QLQ-C30 QoL questionnaire with the QLQ-BR45 module will be filled at inclusion, upon molecular relapse in the experimental arm, upon radiological/clinical relapse in the standard arm, and during post-relapse follow-up. Populations of interest consist in (i) all included patients and (ii) patients who have experienced a molecular relapse and/or a clinical/radiological relapse., Proportion of patients presenting with an altered general condition (PS ≥2) at first evidence of clinical or radiological relapse; 2. OS measured from clinical/radiological relapse., Exploratory: a. Rate of ctDNA analysis technical failures; b. ctDNA analysis turnaround time; c. Rate of 68Ga-FAPI PET-CT technical failures; c/ Rate of 68Ga-FAPI-46 PET-CT technical failures, defined as results being not available because of a technical issue with the scanner or the gamma-camera, an insufficient quality of the radiotracer or of the images generated. d/ Reasons for patient non-adherence to either ctDNA analysis and/or 68Ga-FAPI-46 PET-CT will be registered., Exploratory: 1/ Rate of patients with ctDNA detected and with tumor deposits detected with 68Ga-FAPI-46 PET-CT: 2/ Comparison of 68Ga-FAPI-46 PET-CT with the rest of the imaging procedures (including 18F-FDG PET-CT) in terms of: a/ Rate of patients with tumor deposits detected; b/ Number of metastases identified in each organ/system, Exploratory: Associations between quantitative/qualitative results of the primary tumor genomic landscape, digital pathology features, ctDNA detection, 18F-FDG PET-CT and 68Ga-FAPI-46 PET-CT results, patients’ characteristics and outcomes., Exploratory: Quantitative changes in ctDNA levels three, six and nine months after treatment start, in relapsed patients., Exploratory: Supplemental molecular analyses will be performed on banked plasma and optional biopsies (fresh and frozen) performed at relapse ; available tissue sections will be centralized at the end of the study for additional image analyses, to explore potential, Exploratory: Cost-effectiveness analysis of 68Ga-FAPI-46 PET-CT + ctDNA compared to the existing surveillance strategies.

Source: https://euclinicaltrials.eu/ctis-public/view/2022-501562-22-01